EU clinical trial 2025-524148-36-00: Randomised open-label pilot Study on Thiamine supplementation to REduce braiN injury associated with chronic Alcohol use in outpatients with alcohol use disorder : STRENA
Protocol code: C25-96
Sponsor: Institut National De La Sante Et De La Recherche Medicale (Laboratory/Research/Testing facility). Phase: Therapeutic exploratory (Phase II). Countries: France (authorised, recruitment pending).
Therapeutic area(s): Psychiatry and Psychology [F] - Mental Disorders [F03]
Gender: Female, Male. Age: 18-64 years. Enrolment: 60.
Status: Authorised, recruitment pending. Decision date: 2026-06-29. Results received: No. Last updated: 2026-06-29.

Condition(s): Alcoholism
Product: THIAMINE (VIT B1)

Primary endpoint: The primary endpoint is the change in plasma light neurofilaments (NFL) between the day treatment began (T1; Day 0) and after 14 days of treatment (T2) (days 14, 15, or 16), comparing the thiamine treatment group with the control group without supplementation (time × treatment interaction in a repeated-measures analysis of variance (ANOVA)), in an intention-to-treat (ITT) analysis, adjusted for sex (phenotype assigned at birth) and age.
Endpoint(s): Repeated-measures ANOVA of plasma NFL levels (T1–T2): (1) effect of thiamine supplementation vs control (time × treatment interaction) in per-protocol analysis with ≥80% adherence, adjusted for age and sex; (2) in ITT, effect of supplementation, morning alcohol withdrawal symptoms, and their interaction; (3) in ITT, effect of supplementation, reported morning alcohol consumption, and their interaction, adjusted for age and sex., Variation in plasma GFAP and total Tau levels between T1 and T2 will be compared between the thiamine supplementation group and the control group without supplementation using repeated-measures ANOVA (time × treatment interaction), in an intention-to-treat (ITT) analysis adjusted for age and sex., Additional analyses of treatment effect variability using plasma NFL: repeated-measures ANOVA (T1–T2) assessing supplementation effect (time×treatment), daily alcohol intake at T1, psychostimulant use, or OAT use, and their interactions (ITT, adjusted for age and sex). Linear regression between changes in NFL and alcohol intake. Associations of NFL at T1 with clinical and social factors, followed by multivariate analysis (p≤0.10)., Plasma GFAP variation between T1 and T2 compared between thiamine and control groups using repeated-measures ANOVA (time×treatment), per-protocol (≥80% adherence), adjusted for age and sex. In ITT, analyses assess supplementation, withdrawal symptoms, morning alcohol use, alcohol quantity at T1, psychostimulant or OAT use and interactions. Linear regressions between GFAP and alcohol changes; associations at T1 with clinical/social factors, then multivariate analysis (p<0.10)., Plasma total Tau variation between T1 and T2 compared between thiamine and control groups using repeated-measures ANOVA (time×treatment), per-protocol (≥80% adherence), adjusted for age and sex. In ITT, analyses assess supplementation, withdrawal symptoms, morning alcohol use, alcohol quantity at T1, psychostimulant or OAT use and interactions. Linear regressions between Tau and alcohol changes, associations at T1 with clinical and social factors, followed by multivariate analysis (p≤0.10)., MoCA score analysis: linear regression adjusted for age and sex of the MoCA score at T1 with age and sex alone, morning alcohol withdrawal symptoms, active cocaine use in the previous month, OAT use, EPICES deprivation score, homelessness status, DERS impulsivity subscale, and OCDS score at T1. Multivariate analysis will follow including factors with p≤0.10 in univariate analysis., Alcohol craving analysis: change in OCDS score between T1 and T2 compared between thiamine and control groups using repeated-measures ANOVA (time×treatment) in ITT, adjusted for age and sex. Linear regressions between changes in plasma NFL, GFAP, and Tau and changes in OCDS score, adjusted for age and sex., Treatment adherence analysis: linear regression adjusted for age and sex for good adherence (≥45 tablets out of 56) with age, sex, daily alcohol consumption at inclusion, morning withdrawal symptoms, morning alcohol use, active cocaine use, OAT use, EPICES deprivation score, homelessness status, MoCA score, DERS impulsivity subscale, and OCDS score at T1. Multivariate analysis will follow including factors with p≤0.10 in univariate analysis, adjusted for age and sex., Proteome analysis: change in plasma proteins between T1 and T2 compared between thiamine and control groups using repeated-measures ANOVA (time×treatment) in ITT, adjusted for age and sex, with correction for multiple testing.

Source: https://euclinicaltrials.eu/ctis-public/view/2025-524148-36-00